EU clinical trial 2025-520560-18-00: A phase 2 immunoPET imaging study with ZED88082A/CED88004S in patients with large B-cell lymphoma before and after CD19-directed CAR T-cell therapy
Sponsor: Universitair Medisch Centrum Groningen (Hospital/Clinic/Other health care facility). Phase: Phase II and Phase III (Integrated). Countries: Netherlands (ended).
Therapeutic area(s): Diseases [C] - Hemic and Lymphatic Diseases [C15]
Gender: Female, Male. Age: 18-64 years, 65+ years. Enrolment: 27.
Status: Ended. Start date (EU): 2026-05-22. End date (EU): 2026-05-22. Decision date: 2025-01-30. Results received: No. Last updated: 2025-01-30.

Condition(s): Large B-cell lymphoma
Product: 89Zr-CED88004S

Primary endpoint: To determine the whole-body biodistribution of the ZED88082A tracer in normal tissues and tumor lesions before and after CAR T-cell therapy. Heterogeneity of ZED88082A/CED88004S uptake evaluated by measuring standardized uptake value (SUV) on the ZED88082A/CED88004S-PET scan 2 days after ZED88082A/CED88004S injection.
Endpoint(s): Assess safety and dosimetry ZED88082A/CED88004S uptake in the setting of CD19- directed CAR T-cell therapy, Correlative expression analysis between ZED88082A tracer SUV parameters in the tumor, CD8 expression in tumor biopsy, and response to CAR T-cell therapy, To perform correlative expression analysis between SUV parameters of ZED88082A tracer in the tumor, CD8 expression in tumor biopsy, and SUV parametersin the tumor and whole-body and CAR T-cell persistence, peak level and CAR T-cell phenotype as measured in the peripheral blood., Correlative expression analysis between ZED88082A tracer SUV parameters in the tumor, and grade 1-5 adverse events to CAR T-cell therapy, including cytokine release syndrome and neurotoxicity., to correlate ZED88082A/CED88004S uptake in lymphoma to radiated to non-radiated areas infield and outfield of radiation therapy in patients receiving radiation therapy that require bridging to CAR T-cell infusion

Source: https://euclinicaltrials.eu/ctis-public/view/2025-520560-18-00